EU clinical trial 2024-513688-25-01: A blinded randomized study investigating the effect of pericapsular nerve group (PENG) block on postoperative pain after peri-acetabular osteotomy
Sponsor: Rigshospitalet (Hospital/Clinic/Other health care facility). Phase: Therapeutic use (Phase IV). Countries: Denmark (ongoing, recruiting).
Therapeutic area(s): Analytical, Diagnostic and Therapeutic Techniques and Equipment [E] - Anesthesia and Analgesia [E03]
Gender: Female, Male. Age: 18-64 years. Enrolment: 90.
Status: Ongoing, recruiting. Start date (EU): 2024-08-19. Decision date: 2024-06-25. Results received: No. Last updated: 2026-03-26.

Condition(s): periacetabular osteotomy
Product: Ropivacaine Kabi 5 mg/ml solution for injetion, SALINE

Primary endpoint: Area under curve (AUC) of pain reported on a numeric rating scale (NRS) from 0 to 10 during the first 24 hours postoperatively
Endpoint(s): The number of patients reporting moderate to severe pain at rest [>3 out of 10 on a numeric rating scale (NRS) from 0 to 10] at any point in the immediate postoperative phase (from arrival at the PACU until transfer to the ward). NRS will be assessed upon arrival at the PACU and each 30 minutes., Pain during during mobilization (from laying down in bed till standing on the floor) assessed on a NRS at 5 hours after extubation, Opioid use from tracheal extubation until 24 hours postoperatively

Source: https://euclinicaltrials.eu/ctis-public/view/2024-513688-25-01